EU clinical trial 2022-502177-42-02: A multicentre, triple blind, placebo controlled, parallel group study of atorvastatin in chronic migraine
Protocol code: 2022-502177-42-02
Sponsor: St. Olavs Hospital HF (Hospital/Clinic/Other health care facility). Phase: Therapeutic exploratory (Phase II). Countries: Norway (ongoing, recruiting).
Therapeutic area(s): Diseases [C] - Nervous System Diseases [C10]
Gender: Female, Male. Age: 18-64 years. Enrolment: 300.
Status: Ongoing, recruiting. Start date (EU): 2024-05-13. Decision date: 2023-06-23. Results received: No. Last updated: 2024-06-20.

Condition(s): Chronic migraine
Product: ATORVASTATIN, PLACEBO

Primary endpoint: Difference between groups receiving atorvastatin 40 mg daily and placebo in change from baseline in number of migraine days per 4 weeks
Endpoint(s): Difference between groups receiving atorvastatin 40 mg daily and placebo in change from baseline in number of days with headache, Number of reported side effects in the placebo and atorvastatin 40 mg, Comparison of cost in the placebo and atorvastatin treatment, taking into consideration price of the medicine, price of acute medication, and lost worktime

Source: https://euclinicaltrials.eu/ctis-public/view/2022-502177-42-02